EU clinical trial 2024-518683-13-00: Tailoring antibiotic duration for respiratory tract infections in primary care. A pragmatic randomised clinical trial [STORM Study]
Protocol code: IJG-STORM-2024
Sponsor: Institut Universitari D Investigacio En Atencion Primaria Jordi Gol (Laboratory/Research/Testing facility). Phase: Therapeutic use (Phase IV). Countries: Spain (ongoing, recruiting).
Therapeutic area(s): Diseases [C] - Respiratory Tract Diseases [C08]
Gender: Female, Male. Age: 18-64 years, 65+ years. Enrolment: 474.
Status: Ongoing, recruiting. Start date (EU): 2025-11-12. Decision date: 2025-08-12. Results received: No. Last updated: 2025-10-03.
Decision dates by country: ES: 2025-10-03

Condition(s): Acute lower Respiratory Tract Infection or acute rhinosinusitis

Primary endpoint: Clinical resolution is defined as disappearance of fever, disappearance or improvement in overall condition, such that no additional antimicrobial treatment is necessary. Any other clinical outcome that does not meet the definition is considered treatment failure
Endpoint(s): Concordance of the antibiotic doses taken with the recommended guidelines, as recorded in the questionnaire and self-registered RTI symptom diaries, Number of patients discontinuing treatment in both groups and what day they discontinue recorded in the self-registered RTI symptom diaries and eCAP, First day the patient feels better, as recorded in the questionnaire and self-registered RTI symptom diaries, Antibiotics others than the study medication and other symptomatic therapies within the first two weeks recorded in the self-registered RTI symptom diaries, Number of days until the last day the patient scores 5 in any of the symptoms recorded in the self-registered RTI symptom diaries, Number of days until the last day the patient scores 3 in any of the symptoms recorded in the self-registered RTI symptom diaries, Number of days until the last day the patient scores 0 in all the symptoms recorded in the self-registered RTI symptom diaries, Number of re-attendances to any doctor for new or worsening symptoms regarding the RTI regarding the infection, within 28 days after the index consultation, registered in eCAP, Number of complications related to the infection within 28 days after the index consultation registered in eCAP, such as visits to emergency departments and/or hospital admissions regarding the RTI, Number of days of work absenteeism due to the RTI registered in eCAP within the first 14 days, Difference in health-related quality of life on days 14 and 28, compared to baseline, measured using the EQ-5D-5L instrument, Drug-associated adverse events related to the antibiotic assessed by review of medical notes (practice staff, the local study team, or both using a standard form to report these data) within the first 14 days, Early clinical assessment based on the overall score at Day 7, defined as the total symptom score reported by the patient on that day (mean/median)

Source: https://euclinicaltrials.eu/ctis-public/view/2024-518683-13-00